EU clinical trial 2023-507313-94-00: An Open-Label, Parallel-Group Study to Evaluate Safety, Tolerability, Pharmacokinetics, and Pharmacodynamic Effects of Ocrelizumab in Children and Adolescents with Relapsing-Remitting Multiple Sclerosis
Protocol code: WA39085
Sponsor: F. Hoffmann-La Roche AG (Pharmaceutical company). Phase: Therapeutic exploratory (Phase II). Countries: Italy (ongoing, recruitment ended), Poland (ongoing, recruitment ended).
Therapeutic area(s): Diseases [C] - Nervous System Diseases [C10]
Gender: Female, Male. Age: 0-17 years. Enrolment: 12.
Status: Ongoing, recruitment ended. Start date (EU): 2019-10-18. Decision date: 2023-12-05. Results received: No. Last updated: 2026-06-29.
Decision dates by country: PL: 2024-01-10, IT: 2023-12-05

Condition(s): Relapsing-Remitting Multiple Sclerosis (RRMS)
Product: Ocrevus 300 mg concentrate for solution for infusion, Diphenhydramine Hydrochloride Tablets 50 mg, Methylprednisolone 500 mg powder and solvent for solution for injection/infusion, Ocrevus 300 mg concentrate for solution for infusion, Paracetamol 500mg Tablets

Primary endpoint: 1.Serum concentration of ocrelizumab at specified timepoints, 2.Levels of CD19+ B-cell count in blood
Endpoint(s): 1.Occurrence and severity of adverse events, with severity determined according to National Cancer Institute Common Terminology Criteria for Adverse Events version 5.0 (NCI CTCAE v5.0), 2.Change from baseline in vital signs, 3.Change from baseline in clinical laboratory test results, 4.Level of circulating B cells, T cells, natural killer cells, and other leukocytes, 5.Developmental milestones (e.g., growth, bone age, age at menarche, Tanner staging), 6.Non-MS central nervous system (CNS) pathology as measured by brain MRI scans, 7.Levels of blood immunoglobulins, 8.Antibody titers against standard vaccines, 9.Presence of ADAs during the study relative to the presence of ADAs at baseline

Source: https://euclinicaltrials.eu/ctis-public/view/2023-507313-94-00